EU clinical trial 2023-503713-29-00: Independent, multicenter, phase IV, randomized, double-blind, parallel-group clinical trial in people with Parkinson's Disease under stable dopaminergic treatment with persistent fatigue symptoms, randomized 1:1 to adjunctive treatment with safinamide (100 mg/day) or rasagiline (1 mg/day) for 24 weeks.
Protocol code: IIBSP-FAT-2023-24
Sponsor: Fundacio Institut De Recerca De L Hospital De La Santa Creu I Sant Pau (Hospital/Clinic/Other health care facility). Phase: Therapeutic use (Phase IV). Countries: Spain (ongoing, recruiting).
Therapeutic area(s): Diseases [C] - Nervous System Diseases [C10]
Gender: Female, Male. Age: 18-64 years, 65+ years. Enrolment: 50.
Status: Ongoing, recruiting. Start date (EU): 2023-12-13. Decision date: 2023-09-07. Results received: No. Last updated: 2025-07-23.

Condition(s): Fatigue symptoms associated with Parkinson´s Disease.
Product: SAFINAMIDE, RASAGILINE

Primary endpoint: Changes in the Fatigue Severity Scale (FSS) score.

Source: https://euclinicaltrials.eu/ctis-public/view/2023-503713-29-00